EU clinical trial 2023-503670-21-00: Randomized Phase III Study of Standard Intensive Chemotherapy versus Intensive Chemotherapy with CPX-351 in Adult Patients with Newly Diagnosed AML and Intermediate- or Adverse Genetics
Protocol code: AMLSG 30-18
Sponsor: Universitaetsklinikum Ulm AöR (Hospital/Clinic/Other health care facility). Phase: Therapeutic confirmatory (Phase III). Countries: Austria (ongoing, recruitment ended), Germany (ongoing, recruitment ended).
Therapeutic area(s): Diseases [C] - Hemic and Lymphatic Diseases [C15]
Gender: Female, Male. Age: 18-64 years, 65+ years. Enrolment: 883.
Status: Ongoing, recruitment ended. Start date (EU): 2019-08-28. Decision date: 2024-02-15. Results received: No. Last updated: 2026-07-06.
Decision dates by country: AT: 2024-02-19, DE: 2024-02-15

Condition(s): Patients with newly diagnosed AML and intermediate- or adverse-risk genetics (according to 2017 ELN criteria), including AML with myelodysplasia-related changes (AML-MRC) and therapy-related AML according to the World Health Organization (WHO) classification
Product: CYTARABINE, Vyxeos Liposomal 44 mg/100 mg powder for concentrate for solution for infusion., DAUNORUBICIN

Primary endpoint: Event-free survival (EFS), defined as the time from randomization to induction failure, death or relapse after achieving CR or CRi, whichever occurs first, based on response assessed by the investigator in the restricted set of de novo patients.
Endpoint(s): Event-free survival (EFS) (with CR/CRi considered as response to induction therapy) in the extended set of patients, Overall survival (OS), defined as the time from randomization to death from any cause, in the restricted set of de novo patients. Patients still alive or lost to follow up will be censored at the time they were last known to be alive, Overall survival (OS) in the extended set of patients, Event-free survival (EFS) (with CRi considered as failure of induction therapy) in the restricted set of de novo patients, Rate of objective responses (complete remission [CR], CR with incomplete hematologic recovery [CRi], CRi without measurable residual disease [CRiMRD-], CR without measurable residual disease [CRMRD-]) at the end of induction chemotherapy. Absence of measurable residual disease is defined as negativity for leukemia-associated immunophenotypes (LAIP) by multi-parameter flow cytometry (MFC). Based on the restricted set of de novo patients.

Source: https://euclinicaltrials.eu/ctis-public/view/2023-503670-21-00